EU clinical trial 2024-514605-61-00: Effectiveness and Safety of Intra-Dermal Hepatitis B Vaccination after topical application of IMIQUIMOD, in cirrhotic patients, who did not respond to the conventional vaccine regimen: a pilot study
Protocol code: 2020PI198
Sponsor: CHRU De Nancy (Hospital/Clinic/Other health care facility). Phase: Therapeutic exploratory (Phase II). Countries: France (ended).
Therapeutic area(s): Diseases [C] - Immune System Diseases [C20]
Gender: Female, Male. Age: 18-64 years, 65+ years. Enrolment: 60.
Status: Ended. Start date (EU): 2022-07-08. End date (EU): 2025-01-22. Decision date: 2024-06-26. Results received: Yes. Last updated: 2024-06-26.

Condition(s): Cirrhotic patients who have already received a HBV vaccination with a conventional regimen and who have not responded (characterized by a level of antibody Hbs < 10UI/ml at the end of the vaccine regimen)
Product: HEPATITIS B SURFACE ANTIGEN, HEPATITIS B SURFACE ANTIGEN, IMIQUIMOD

Primary endpoint: For each vaccine strategy: proportion of patients with an anti-HBs antibody level greater than 10mUI/mL at M7 from the initial injection.
Endpoint(s): 1) For each vaccine strategy: proportion of patients for whom an anti- HBs antibody level greater than 10mUI/mL is found at M1 from the initial injection., 2) For each vaccine strategy: proportion of patients for whom an anti- HBs antibody level greater than 10mUI/mL is found at M6 from the initial injection., 3) For each vaccine strategy, the evolution of the HB antibody title (in mUI/mL) will be considered: - Between dosages made at M0 and M1 (before versus 1 month of the first injection) - Between dosages at M1 and M6 (before versus 5 months of the 2nd injection) - Between dosages at M6 and M7 (before versus 1 month of the 3rd injection), 4) In patients who received the intradermal vaccine without prior application of Imiquimod: number of side effects and sevre side effects immediately or delayed at the injection site in relation to the number of intradermal injections performed in these patients;, 5) In patients who received the intradermal vaccine after prior application of Imiquimod: the number of side effects and severe side effects immediately or delayed at the Imiquimod application area and injection site in relation to the number of intradermal injections after prior application of Imiquimod in these patients.

Source: https://euclinicaltrials.eu/ctis-public/view/2024-514605-61-00